EU clinical trial 2024-514587-44-00: Impact of local tissue inflammation on intramyocardial conduction pathways post percutaneous valve : evaluation by positron emission tomography on exploratory cohort
Protocol code: 29BRC21.0255
Sponsor: Centre Hospitalier Regional Et Universitaire De Brest (Hospital/Clinic/Other health care facility). Phase: Therapeutic exploratory (Phase II). Countries: France (ongoing, recruiting).
Therapeutic area(s): Diseases [C] - Cardiovascular Diseases [C14]
Gender: Female, Male. Age: 18-64 years, 65+ years. Enrolment: 100.
Status: Ongoing, recruiting. Start date (EU): 2024-06-17. Decision date: 2024-06-17. Results received: No. Last updated: 2025-11-07.

Condition(s): Aortic stenosis
Product: FLUDESOXYGLUCOSE (18F)-CURIUM 185 MBq/mL, solution injectable

Primary endpoint: Intra-hospital "occurrence of a conductive disorder", a composite criterion comprising: 1) complete AVB, 2) high-grade AVB, 3) LBB, 4) RBB, 5) AVB1; assessed by electrocardiograms (ECG post percutaneous valve implantation) performed during the initial hospitalization
Endpoint(s): Post-TAVI pacemaker implantation, Post-TAVI pacemaker dependence at 1 month, 6 months, "Occurrence of a conductive disorder" within 6 months of discharge from TAVI hospitalization

Source: https://euclinicaltrials.eu/ctis-public/view/2024-514587-44-00